EU clinical trial 2023-510516-39-00: A Phase IIA Study of Feasibility and Effectiveness of Inotuzumab Ozogamicin (IO) in Adult Patients with B-Cell Acute Lymphoblastic Leukemia with positive Minimal Residual Disease before any Hematopoietic Stem Cell Transplantation. ALL2418
Protocol code: ALL2418
Sponsor: Fondazione Gimema Franco Mandelli Onlus (Patient organisation/association). Phase: Therapeutic exploratory (Phase II). Countries: Italy (ongoing, recruitment ended).
Therapeutic area(s): Diseases [C] - Neoplasms [C04]
Gender: Female, Male. Age: 18-64 years, 65+ years. Enrolment: 76.
Status: Ongoing, recruitment ended. Start date (EU): 2019-10-30. Decision date: 2024-12-03. Results received: No. Last updated: 2026-04-23.

Condition(s): Acute B-cell Lymphoblastic Leukemia with minimal residual positive disease prior to haematopoietic stem cell transplantation in adult patients
Product: PONATINIB, CYCLOPHOSPHAMIDE, VINCRISTINE, BESPONSA 1 mg powder for concentrate for solution for infusion, METHOTREXATE, PURINETHOL 50 mg compresse, PREDNISONE

Primary endpoint: Primary end point is % of MRD negativity after course 2 (or course 1 if will be performed only course1).
Endpoint(s): Molecular Disease Progression: defined as the rise of more than 2 log in MRD from any previous determination, Disease Progression: this is also equivalent to Treatment Failure, Lack of Efficacy, or No Response., Overall Survival (OS), defined as the number of days between the first study drug administration and death from any cause or lost to follow up., Event Free Survival (EFS), defined as the number of days between the first study drug administration and any event including disease progressionor death., DFS (Disease Free Survival), defined as the interval between the date of response achievement and the date of death, relapse or last follow-up., Incidence time and nature of any adverse event., Severe effect related to treatment safety is defined as an adverse event occurring within the first cycle, judged to be related to treatment and meeting any of the following criteria: o Grade 3 non-hematological toxicity lasting more than 7 days. o Grade 4 non-hematological toxicity., Incidence, severity, seriousness and treatment-causality of Treatment Emergent Signs and Symptoms., Frequency of clinically significant abnormalities in physical examination, safety laboratory tests, vital signs and 12-Lead ECG., VOD occurred during or after protocol or transplant procedures for up to 2 years.

Source: https://euclinicaltrials.eu/ctis-public/view/2023-510516-39-00